EU clinical trial 2024-517236-22-00: Prospective Randomized Open-label Trial to Evaluate risk faCTor management in patients with Unruptured intracranial aneurysms (PROTECT-U)
Protocol code: PROTECT-U
Sponsor: Heidelberg University (Educational Institution). Phase: Therapeutic confirmatory (Phase III). Countries: Germany (ongoing, recruiting), Finland (ongoing, recruiting), Netherlands (ongoing, recruiting).
Therapeutic area(s): Diseases [C] - Cardiovascular Diseases [C14]
Gender: Female, Male. Age: 18-64 years, 65+ years. Enrolment: 746.
Status: Ongoing, recruiting. Start date (EU): 2017-09-20. Decision date: 2024-11-22. Results received: No. Last updated: 2026-03-11.
Decision dates by country: FI: 2024-11-25, NL: 2024-11-22, DE: 2024-11-25

Condition(s): Intradural saccular unruptured aneurysm
Product: ACETYLSALICYLIC ACID

Primary endpoint: The primary outcome measure will be aneurysm rupture or growth on serial imaging (MR- or CTangiography). Aneurysm growth is defined as an increase in any aneurysm diameter by ≥ 1mm within 36±6 months from randomizantrally by two independent trial radiologists, who will be blinded to the treatment allocation. Events suspicious for SAH but negative CT-imaging will be reviewed centrally by the adjudication committee.
Endpoint(s): Definite aSAH, probable aSAH, or aneurysm growth irrespective of the time since randomization, Definite aSAH, probable aSAH, possible aSAH, or aneurysm growth irrespective of the time since randomization, Increase of aneurysm volume in computerized measurements from source images by >10% and >3mm3 or appearance of daughter sac, Development of de novo aneurysm on serial imaging, Neurosurgical/endovascular treatment of the UIA during the study period, Any ischemic or hemorrhagic stroke, defined as clinical symptoms of stroke AND a compatible lesion on imaging (either plain head CT/CT perfusion/MRI), Myocardial infarction defined as increase of Troponin, CK-MB and/or presence of new significant Q waves obtained on ECG, Vascular death (including fatal stroke, fatal myocardial infarction, sudden death), Major spontaneous bleeding, defined as bleeding requiring hospitalization or leading to death or disability (including definite and probable aSAH, Blood pressure (as measured during follow-up visits), Safety aspects (adverse and serious adverse events, including those mentioned above, see also 8.1.6 and 8.2), Quality of life (as determined by completion of the paper-based EQ-5D-5L form by patient)

Source: https://euclinicaltrials.eu/ctis-public/view/2024-517236-22-00